EU clinical trial 2023-504078-39-01: Pharmacodynamic Outcomes in patients with coronary artery disease undergoing Percutaneous coronary intervention treated with an individualized treatment STRATEGY (POPular STRATEGY PD)
Protocol code: 2023-504078-39-01
Sponsor: St Antonius Hospital (Hospital/Clinic/Other health care facility). Phase: Therapeutic use (Phase IV). Countries: Netherlands (ended).
Therapeutic area(s): Diseases [C] - Cardiovascular Diseases [C14]
Gender: Female, Male. Age: 18-64 years, 65+ years. Enrolment: 88.
Status: Ended. Start date (EU): 2024-01-11. End date (EU): 2026-02-25. Decision date: 2023-06-12. Results received: No. Last updated: 2024-08-26.

Condition(s): Stable coronary artery disease, Chronic coronary syndrome
Product: Efient 10 mg film-coated tablets., Plavix 75 mg film-coated tablets, Brilique 90 mg film-coated tablets, Aspirine 100, 100 mg Tabletten

Primary endpoint: Platelet inhibition by measuring platelet reactivity units (PRU) using the VerifyNow at 30 days after randomization
Endpoint(s): Platelet reactivity measured using Light Transmission Aggregometry (LTA) and Total Thrombus formation Analysis System (T-TAS) at 30 days after randomization., The bleeding (safety) endpoint is the incidence of minor, moderate or severe bleeding (Bleeding Academic Research Consortium 2, 3 and 5) at 6 months., The efficacy endpoint is major adverse ischemic events (cardiovascular mortality, myocardial infarction, stent thrombosis, stroke, urgent target vessel revascularization) at 6 months, Individual components of the primary and secondary end points, Net clinical benefit (a composite of all-cause death, MI, stroke and major bleeding defined as BARC type 3 or 5 bleeding) at 6 months, The number of patients in whom the antiplatelet drug is prematurely discontinued or switched to another drug, The percentage of matching genotype results between the Genomadix and Genedrive test results in the intervention group.

Source: https://euclinicaltrials.eu/ctis-public/view/2023-504078-39-01